EU clinical trial 2023-504564-42-00: A Phase 2, Randomized, Double Blind, Placebo Controlled Study to Evaluate the Efficacy and Safety of Rosnilimab in Subjects with Moderate to Severe Rheumatoid Arthritis
Protocol code: ANB030-203
Sponsor: Anaptysbio Inc. (Pharmaceutical company). Phase: Therapeutic exploratory (Phase II). Countries: Hungary (ended), Slovakia (ended), Spain (ended), Belgium (ended), France (ended), Italy (ended), Germany (ended), Poland (ended), Estonia (ended).
Therapeutic area(s): Diseases [C] - Musculoskeletal Diseases [C05]; Diseases [C] - Immune System Diseases [C20]
Gender: Female, Male. Age: 18-64 years, 65+ years. Enrolment: 200.
Status: Ended. Start date (EU): 2024-04-08. End date (EU): 2025-05-28. End date: 2025-05-29. Decision date: 2024-03-05. Results received: No. Last updated: 2024-09-17.
Decision dates by country: EE: 2024-03-11, HU: 2024-03-11, BE: 2024-04-19, SK: 2024-03-05, IT: 2024-05-13, ES: 2024-03-11, PL: 2024-03-08, FR: 2024-03-08, DE: 2024-05-14

Condition(s): Moderate to Severe Rheumatoid Arthritis
Product: A sterile, preservative-free, colorless to brown-yellow and clear to opalescent solution composed of the same excipients used in the rosnilimab active dp., Rosnilimab

Primary endpoint: Mean change from Baseline in DAS28-CRP at Week 12 (Primary Efficacy Endpoint)
Endpoint(s): ACR20 response rate at Week 12, ACR50 response rate at Week 12, ACR70 response rate at Week 12, Proportion of subjects with DAS28-CRP <3.2 (low disease activity) at Week 12, Proportion of subjects with DAS28-CRP < 2.6 (remission) at Week 12, Proportion of subjects with CDAI <=10 (low disease activity) at Week 12

Source: https://euclinicaltrials.eu/ctis-public/view/2023-504564-42-00